EU clinical trial 2025-520742-29-00: Efficacy and Safety Clinical Trial for Immune-Guided Prevention of CMV Infection in Low-Risk Kidney Transplantation. (INMUNOVIR Study)
Protocol code: FCO-INM-2024-01
Sponsor: Fundacion Para La Investigacion Biomedica De Cordoba (Laboratory/Research/Testing facility). Phase: Therapeutic confirmatory (Phase III). Countries: Spain (ongoing, recruiting).
Therapeutic area(s): Diseases [C] - Virus Diseases [C02]
Gender: Female, Male. Age: 18-64 years, 65+ years. Enrolment: 170.
Status: Ongoing, recruiting. Start date (EU): 2025-12-19. Decision date: 2025-06-26. Results received: No. Last updated: 2025-06-26.

Condition(s): Low-risk renal transplant patients
Product: Ganciclovir Accord 500 mg polvo para concentrado para solución para perfusión EFG, Valganciclovir Normon 450 mg comprimidos recubiertos con película EFG

Primary endpoint: Efficacy: proportion of patients with CMV disease (incidence) at 6 and 12 months after transplantation., Safety: proportion of patients with different degrees of neutropenia at 6 and 12 months after transplantation.
Endpoint(s): Safety: number of days with valganciclovir (at 6 and 12 months post-transplant) and proportion of patients with adverse events occurring at a frequency >10% (at 6 months post-transplant)., Efficacy/safety: CMV disease/neutropenia combination assessed at 6 and 12 months using DOOR ("Desirability of Outcome Ranking"). The best outcome is no CMV disease/replication without neutropenia (<1500 mm³), while the worst is CMV disease/replication with neutropenia. DOOR ranks patient outcomes and estimates the probability of a better result in one group. A >50% probability, with 95% confidence intervals excluding 50%, indicates a significantly better outcome.

Source: https://euclinicaltrials.eu/ctis-public/view/2025-520742-29-00